EU clinical trial 2024-513411-27-00: A randomized, double-blind, placebo-controlled, single-ascending-dose study in healthy volunteers and a double-blind, placebo-controlled, multiple-ascending-dose study in patients with Parkinson’s disease to evaluate the safety, tolerability, and PK/PD of LY3962681.
Protocol code: J5F-MC-OOAA
Sponsor: Prevail Therapeutics Inc. (Pharmaceutical company). Phase: Human Pharmacology (Phase I)- First administration to humans. Countries: Germany (authorised, recruitment pending), Netherlands (authorised, recruitment pending).
Therapeutic area(s): Diseases [C] - Nervous System Diseases [C10]
Gender: Female, Male. Age: 18-64 years, 65+ years. Enrolment: 10.
Status: Authorised, recruitment pending. Decision date: 2025-04-01. Results received: No. Last updated: 2026-06-22.
Decision dates by country: NL: 2025-04-07, DE: 2025-04-01

Condition(s): Parkinson’s disease

Source: https://euclinicaltrials.eu/ctis-public/view/2024-513411-27-00